EU clinical trial 2025-521603-46-00: A study testing a new treatment called TK-6302 for the first time in people with advanced cancers that have a genetic marker called HLA-A02:01 and a tumour protein called PRAME.
Protocol code: TK-6302-01
Sponsor: T-Knife GmbH (Pharmaceutical company). Phase: Human Pharmacology (Phase I)- First administration to humans. Countries: Germany (authorised, recruitment pending).
Therapeutic area(s): Diseases [C] - Neoplasms [C04]
Gender: Female, Male. Age: 18-64 years, 65+ years. Enrolment: 24.
Status: Authorised, recruitment pending. Decision date: 2026-02-27. Results received: No. Last updated: 2026-02-27.

Condition(s): Advanced PRAME Positive Solid Tumors

Source: https://euclinicaltrials.eu/ctis-public/view/2025-521603-46-00